EU clinical trial 2024-519855-27-00: N-acetylcysteine for the treatment of cannabis dependence: working mechanisms
Sponsor: UZ Brussel (Hospital/Clinic/Other health care facility). Phase: Therapeutic use (Phase IV). Countries: Belgium (ended).
Therapeutic area(s): Psychiatry and Psychology [F] - Mental Disorders [F03]
Gender: Female, Male. Age: 18-64 years. Enrolment: 50.
Status: Ended. Start date (EU): 2025-01-15. End date (EU): 2026-02-17. Decision date: 2025-01-15. Results received: No. Last updated: 2025-01-15.

Condition(s): Cannabis dependence
Product: Acetylcysteïne Teva 600 mg, poeder voor oraal gebruik, Placebo Tablet 7mm Lichtenstein

Primary endpoint: Day 14 after study start.

Source: https://euclinicaltrials.eu/ctis-public/view/2024-519855-27-00